EU clinical trial 2025-521636-10-00: A Multi-Center, Double-Blind, Placebo-Controlled, Phase II Study Evaluating the Safety, Pharmacokinetics, Pharmacodynamics, and Efficacy of RO7268489, A Monoacylglycerol Lipase Inhibitor, as Add-On Therapy to Ocrelizumab, in Participants with Progressive Forms of Multiple Sclerosis
Protocol code: BP46016
Sponsor: F. Hoffmann-La Roche AG (Pharmaceutical company). Phase: Therapeutic exploratory (Phase II). Countries: Germany (ongoing, recruiting), Spain (ongoing, recruiting), France (ongoing, recruiting), Hungary (ongoing, recruiting), Italy (ongoing, recruiting), Poland (ongoing, recruiting), Portugal (ongoing, recruiting).
Therapeutic area(s): Diseases [C] - Nervous System Diseases [C10]
Gender: Female, Male. Age: 18-64 years. Enrolment: 235.
Status: Ongoing, recruiting. Start date (EU): 2026-02-04. Decision date: 2026-01-28. Results received: No. Last updated: 2026-05-18.
Decision dates by country: FR: 2026-01-30, IT: 2026-02-05, HU: 2026-01-30, PT: 2026-04-09, DE: 2026-01-28, ES: 2026-01-29, PL: 2026-01-30

Condition(s): Progressive Forms of Multiple Sclerosis (PMS)
Product: RO7268489, Ocrevus 300 mg concentrate for solution for infusion, Ocrevus 300 mg concentrate for solution for infusion, RO7268489 Placebo, RO7268489, RO7268489, RO7268489

Primary endpoint: Time from randomization to the first occurrence of composite confirmed disability progression confirmed for at least 12 weeks (cCDP12) according to at least one of the following three criteria: o 12-week confirmed disability progression (CDP12) o 12-week confirmed increase in Timed 25-Foot Walk Test (T25FWT) or o 12-week confirmed increase in 9-Hole Peg Test (9-HPT)
Endpoint(s): Time from randomization to the first occurrence of 24-week confirmed ≥ 4-point decrease (worsening) in Symbol Digit Modalities Test (SDMT), Plasma 2-arachidonoylglycreol (2-AG) levels, Change from baseline in plasma 2-AG levels, Incidence, severity, and causal relationship of adverse events (AEs), Incidence of treatment discontinuations due to AEs, Changes in vital signs and ECG parameters, Incidence of abnormal laboratory findings, Proportion of participants with suicidal ideation or behavior, as assessed by Columbia-Suicide Severity Rating Scale (C-SSRS), Plasma concentrations of RO7268489 and its metabolite(s) as appropriate

Source: https://euclinicaltrials.eu/ctis-public/view/2025-521636-10-00